EU clinical trial 2022-503112-17-00: A Phase 3 Multinational, Open-label, Systemic Gene Delivery Study to Evaluate the Safety and Efficacy of SRP-9003 in Subjects with Limb Girdle Muscular Dystrophy 2E/R4 (EMERGENE)
Protocol code: SRP-9003-301
Sponsor: Sarepta Therapeutics Inc. (Pharmaceutical company). Phase: Therapeutic confirmatory (Phase III). Countries: Spain (ended), Germany (ended), Belgium (ongoing, recruitment ended), Italy (ongoing, recruitment ended).
Therapeutic area(s): Diseases [C] - Musculoskeletal Diseases [C05]
Gender: Female, Male. Age: 0-17 years, 18-64 years, 65+ years. Enrolment: 8.
Start date (EU): 2024-10-16. Decision date: 2024-06-03. Results received: No. Last updated: 2026-07-17.
Decision dates by country: ES: 2024-06-10, DE: 2024-06-06, BE: 2024-06-03, IT: 2024-06-07

Condition(s): Limb-girdle muscular dystrophy, type 2E/R4 (LGMD2E/R4) or β-sarcoglycanopathy
Product: PREDNISONE, PREDNISONE, PREDNISONE, SRP-9003

Primary endpoint: Change from Baseline in β-SG expression at Day 60 post-dose as measured by IF PβSGPF for subjects in Cohort 1 (ambulatory subjects)
Endpoint(s): Change from Baseline in β-SG expression at Day 60 post-dose as measured by IF PβSGPF for subjects in Cohort 1 (ambulatory subjects), Change from Baseline in β-SG expression at Day 60 post-dose for subjects in Cohorts 1 (ambulatory subjects) and 2 (non-ambulatory subjects) as measured by IF PFI, Change from Baseline in β-SG expression at Day 60 post-dose as measured by Western, Change from Baseline in β-SG expression at Day 60 post-dose as measured by IF PβSGPF for subjects in Cohort 2 (non-ambulatory subjects), Change from Baseline through Month 60 in the following physical function for subjects in Cohorts 1(ambulatory subject) and 2 (non-ambulatory subject) − NSAD total score − PUL 2.0 total score, Change from Baseline through Month 60 in the following timed function tests for subjects in Cohort 1 (ambulatory subject): − Time to rise from the floor − Time to complete the 10MWR − Time to ascend 4 steps − Time to complete the 100MWR − Timed up and go, Incidence of TEAEs, Incidence of adverse events of special interest, Incidence of treatment-emergent SAEs, Incidence of clinically significant laboratory abnormalities, Clinically significant changes in ECGs, ECHOs, Change from Baseline through Month 60 in CK level, Time to change of disease milestones

Source: https://euclinicaltrials.eu/ctis-public/view/2022-503112-17-00